EU clinical trial 2023-510280-35-00: Effective strategy of withdrawal of pharmacological treatment of urinary incontinence in children (StayDry)
Protocol code: StayDry-2023
Sponsor: Region Midtjylland (Hospital/Clinic/Other health care facility). Phase: Therapeutic use (Phase IV). Countries: Denmark (ongoing, recruitment ended).
Therapeutic area(s): Diseases [C] - Female Urogenital Diseases and Pregnancy Complications [C13]; Diseases [C] - Male Urogenital Diseases [C12]
Gender: Female, Male. Age: 0-17 years. Enrolment: 216.
Status: Ongoing, recruitment ended. Start date (EU): 2024-05-27. Decision date: 2024-04-22. Results received: No. Last updated: 2024-05-22.

Condition(s): Daytime urinary incontinence
Product: SOLIFENACIN, MIRABEGRON

Primary endpoint: The primary outcome measure is recurrence of incontinence after withdrawal and up to 12 months follow-up, assessed by 14-day calendar of incontinence episodes.
Endpoint(s): Secondary outcome measures are development of any withdrawal symptoms, assessed by questionnaire on withdrawal symptoms (Appendix 2), change from baseline up to 44 days after initiation of withdrawal.

Source: https://euclinicaltrials.eu/ctis-public/view/2023-510280-35-00